EU clinical trial 2024-519652-90-01: Pilot study on the safety and feasibility of intravenous opioid agonist therapy (OAT) with Hydagelan® (hydromorphone hydrochloride) in Vienna.
Protocol code: SHW01
Sponsor: Suchthilfe Wien gGmbH (Hospital/Clinic/Other health care facility). Phase: Therapeutic exploratory (Phase II). Countries: Austria (ended).
Therapeutic area(s): Psychiatry and Psychology [F] - Mental Disorders [F03]
Gender: Female, Male. Age: 18-64 years, 65+ years. Enrolment: 30.
Status: Ended. Start date (EU): 2025-02-17. End date (EU): 2025-11-30. Decision date: 2025-02-17. Results received: No. Last updated: 2025-11-10.

Condition(s): Opioid dependence: Opioid dependence is a serious and usually chronic disease that requires treatment, encompasses various psychological and physical dimensions, and is associated with concomitant diseases and increased mortality.
Product: Hydagelan 50 mg/ml Injektions-/Infusionslösung, Hydagelan 10 mg/ml Injektions-/Infusionslösung, Hydagelan 20 mg/ml Injektions-/Infusionslösung

Primary endpoint: - Reduction of intravenous opioid use outside the medical setting. - Feasibility of implementation and execution
Endpoint(s): - Reduction in co-drug use - Safety of the intervention - Improvement in health status - Retention in treatment

Source: https://euclinicaltrials.eu/ctis-public/view/2024-519652-90-01